EU clinical trial 2022-501414-53-00: MODAFIMS: An open-label, single-center clinical trial to evaluate predictors of response to MODAFinil in the treatment of cognitive deficits in patients with Multiple Sclerosis
Protocol code: MODAFIMS
Sponsor: CCAB Centro Clinico Academico Braga Associacao (Pharmaceutical company). Phase: Therapeutic exploratory (Phase II). Countries: Portugal (ongoing, recruiting).
Therapeutic area(s): Diseases [C] - Nervous System Diseases [C10]
Gender: Female, Male. Age: 18-64 years. Enrolment: 64.
Status: Ongoing, recruiting. Start date (EU): 2024-08-21. Decision date: 2024-06-07. Results received: No. Last updated: 2025-03-18.

Condition(s): Multiple sclerosis
Product: Modafinil Generis 100 mg comprimidos

Primary endpoint: Changes in brain function and connectivity measured using resting state fMRI (at baseline and after 3 months of treatment with Modafinil). Functional MRI will be performed at baseline, before and 3h (±30 min) after Modafinil administration, and at the end of treatment (3-month visit).
Endpoint(s): Changes in brain function and connectivity measured using a Go/no-Go task fMRI., Changes in patient reported outcomes (PROs) and neuropsychological tests - Perceived Deficits Questionnaire (PDQ), Symbol Digit Modalities Test (SDMT), Stroop test measured as interference index, MS-specific QoL questionnaire, Work Productivity and Activity Impairment Questionnaire for MS (WPAI:MS) and Modified Fatigue Impact Scale (MFIS). These assessments will occur in the screening or baseline visits and at the end of treatment (3-month visit).

Source: https://euclinicaltrials.eu/ctis-public/view/2022-501414-53-00